EU clinical trial 2023-504143-14-00: Metamizole as pain treatment in patients with chronic pancreatitis, a multicenter, randomized, double-blind, placebo-controlled trial.
Sponsor: Stichting Radboud University Medical Center (Hospital/Clinic/Other health care facility). Phase: Therapeutic use (Phase IV). Countries: Netherlands (ongoing, recruiting).
Therapeutic area(s): Diseases [C] - Digestive System Diseases [C06]
Gender: Female, Male. Age: 18-64 years, 65+ years. Enrolment: 76.
Status: Ongoing, recruiting. Start date (EU): 2024-05-02. Decision date: 2023-10-11. Results received: No. Last updated: 2025-03-31.

Condition(s): Chronic pancreatitis
Product: Placebo metamizole sodium monohydrate 500 mg film-coated tablet, Dolamizol 500 mg tablet

Primary endpoint: Mean daily pain intensity score, recorded during the 4-week intervention by the patient using a 11-point numerical rating (0 = no pain to 10 = worst pain imaginable)
Endpoint(s): Izbicki pain score, COMPAT-SF, mean of maximum daily pain intensity score, number of patients achieving successful pain reduction, number of pain free days, number of days with acceptable pain, total amount of milligrams morphine equivalent (MME) and MME required as escape medication, QoL (PANQOLI and SF-36), patient satisfaction (PGIC), side effects

Source: https://euclinicaltrials.eu/ctis-public/view/2023-504143-14-00